EU clinical trial 2023-507964-38-00: HERTHENA–Lung02: A Phase 3, Randomized, Open-label Study of Patritumab Deruxtecan Versus Platinum-based Chemotherapy in Metastatic or Locally Advanced Epidermal Growth Factor Receptor-mutated (EGFRm) Non-small Cell Lung Cancer (NSCLC) After Failure of Epidermal Growth Factor Receptor (EGFR) Tyrosine Kinase Inhibitor (TKI) Therapy
Protocol code: U31402-A-U301
Sponsor: Daiichi Sankyo Inc. (Pharmaceutical company). Phase: Therapeutic confirmatory (Phase III). Countries: Italy (ended), Netherlands (ended), Poland (ended), Austria (ended), France (ongoing, recruitment ended), Spain (ongoing, recruitment ended), Belgium (ongoing, recruitment ended), Germany (ended), Portugal (ended), Norway (ended).
Therapeutic area(s): Diseases [C] - Neoplasms [C04]
Gender: Female, Male. Age: 18-64 years, 65+ years. Enrolment: 183.
Start date (EU): 2022-09-01. Decision date: 2024-10-08. Results received: No. Last updated: 2026-07-27.
Decision dates by country: PL: 2024-10-13, NL: 2024-10-11, NO: 2024-10-09, PT: 2024-10-15, DE: 2024-10-08, AT: 2024-10-14, IT: 2024-10-21, ES: 2024-10-16, BE: 2024-10-08, FR: 2024-10-09

Condition(s): Metastatic or Locally Advanced Epidermal Growth Factor Receptor-mutated (EGFRm) Non-small Cell Lung Cancer (NSCLC)
Product: CARBOPLATIN, PEMETREXED, CISPLATIN, CARBOPLATIN, Patritumab deruxtecan

Primary endpoint: Progression free survival (PFS) as assessed by blinded independent central review (BICR) based on RECIST v1.1
Endpoint(s): Overall survival (OS), Progression-free survival (PFS) as assessed by the Investigator per RECIST v1.1, Progression-free survival on the next line of therapy (PFS2) as assessed by local standard clinical practice, Objective response rate (ORR) as assessed by BICR and as assessed by the Investigator per RECIST v1.1, Duration of response (DoR) as assessed by BICR and as assessed by the Investigator per RECIST v1.1, Clinical benefit rate (CBR) as assessed by BICR and as assessed by the Investigator per RECIST v1.1, Disease control rate (DCR) as assessed by BICR and as assessed by the Investigator per RECIST v1.1, Time to response (TTR) as assessed by BICR and as assessed by the Investigator per RECIST v1.1, Patient-reported outcome (PRO) of disease-related symptoms, functioning scales, and general health status and overall quality of life, Intracranial progression-free survival (PFS) as assessed by BICR per CNS—RECIST.

Source: https://euclinicaltrials.eu/ctis-public/view/2023-507964-38-00